EU clinical trial 2025-524344-35-00: Achieve - ACetazolamide in patients with Heart failure, to decrease weight and relIEVE symptoms
Protocol code: RECHMPL24_0295
Sponsor: Centre Hospitalier Universitaire De Montpellier (Hospital/Clinic/Other health care facility). Phase: Therapeutic confirmatory (Phase III). Countries: France (authorised, recruitment pending).
Therapeutic area(s): Diseases [C] - Cardiovascular Diseases [C14]
Gender: Female, Male. Age: 18-64 years, 65+ years. Enrolment: 1050.
Status: Authorised, recruitment pending. Decision date: 2026-06-15. Results received: No. Last updated: 2026-06-15.

Condition(s): Heart failure
Product: DIAMOX* 250mg Tablets

Primary endpoint: Percentage of patients with weight loss > 2kg on connected scale (Remote telemonitoring system) on D5 in each of the two groups (experimental vs control)
Endpoint(s): Percentage of weight variation between D0 and D5, Diuretic effectiveness on D5 calculated by calculating natriuresis corrected by mg of furosemide equivalence from the urinary ionogram performed on D5, Evolution of NtproBNP between D0 and D5, Evolution of the EQ-5D-5L value between D0 and D5, Evolution of the VAS score for dyspnea between D0 and D5, Rate of unplanned/emergency consultation or hospitalization for HF at D90, Rate of deaths from all causes or for HF at D90, Evolution of clinical (weight, VAS dyspnea, BP, HR, RHF and LHF signs) and biological (NtproBNP) between D5 and D15, Evolution of clinical (weight, VAS dyspnea, BP, HR, RHF and LHF signs) and biological (NtproBNP) at D15

Source: https://euclinicaltrials.eu/ctis-public/view/2025-524344-35-00